EU clinical trial 2025-523088-39-00: A Phase 1 Study for ZW251 in Participants with Solid Tumors.
Protocol code: ZWI-ZW251-101
Sponsor: Zymeworks Bc Inc. (Pharmaceutical company). Phase: Human Pharmacology (Phase I)- First administration to humans. Countries: Portugal (ongoing, recruiting), Ireland (ongoing, recruiting), Spain (ongoing, recruiting).
Therapeutic area(s): Diseases [C] - Neoplasms [C04]
Gender: Female, Male. Age: 18-64 years, 65+ years. Enrolment: 31.
Status: Ongoing, recruiting. Start date (EU): 2026-01-28. Decision date: 2026-01-15. Results received: No. Last updated: 2026-06-03.
Decision dates by country: ES: 2026-01-15, IE: 2026-01-16, PT: 2026-01-16

Condition(s): Advanced Solid Tumors

Source: https://euclinicaltrials.eu/ctis-public/view/2025-523088-39-00